EU clinical trial 2023-508279-36-00: A study to compare the pharmacokinetics of salbutamol administered via metered dose inhalers containing propellants HFA-152a (test) or HFA-134a (reference) in healthy participants aged 18 to 55 inclusive.
Protocol code: 219728
Sponsor: Glaxosmithkline Research & Development Limited (Pharmaceutical company). Phase: Human Pharmacology (Phase I)- Other. Countries: Netherlands (ended).
Therapeutic area(s): Diseases [C] - Respiratory Tract Diseases [C08]
Gender: Female, Male. Age: 18-64 years. Enrolment: 60.
Status: Ended. Start date (EU): 2024-05-22. End date (EU): 2024-10-22. Decision date: 2024-05-21. Results received: No. Last updated: 2024-05-21.

Condition(s): Healthy volunteers

Source: https://euclinicaltrials.eu/ctis-public/view/2023-508279-36-00